EU clinical trial 2023-503682-39-00: A clinical study of MK-8527 in people with HIV-1 (MK-8527-004)
Protocol code: MK-8527-004
Sponsor: Merck Sharp & Dohme LLC (Pharmaceutical company). Phase: Human Pharmacology (Phase I)- Other. Countries: Romania (ended).
Therapeutic area(s): Diseases [C] - Virus Diseases [C02]
Gender: Female, Male. Age: 18-64 years. Enrolment: 5.
Status: Ended. Start date (EU): 2023-11-13. End date (EU): 2024-01-31. End date: 2024-02-20. Decision date: 2023-06-16. Results received: No. Last updated: 2023-11-13.

Condition(s): HIV-1 (Human Immunodeficiency Virus Type 1)

Source: https://euclinicaltrials.eu/ctis-public/view/2023-503682-39-00